EU clinical trial 2023-505311-20-01: Phase 3, Two-stage, Randomized Study of ONC-392 Versus Docetaxel in Metastatic Non-Small Cell Lung Cancers that Progressed on PD-1/PD-L1 Inhibitors (PRESERVE-003)
Protocol code: PRESERVE-003
Sponsor: Oncoc4 Inc. (Pharmaceutical company). Phase: Therapeutic confirmatory (Phase III). Countries: Belgium (ongoing, recruiting), Netherlands (ongoing, recruiting), Italy (ongoing, recruiting), Germany (ongoing, recruiting), Spain (ongoing, recruiting).
Therapeutic area(s): Diseases [C] - Neoplasms [C04]
Gender: Female, Male. Age: 18-64 years, 65+ years. Enrolment: 86.
Status: Ongoing, recruiting. Start date (EU): 2025-03-21. Decision date: 2024-10-23. Results received: No. Last updated: 2026-07-28.
Decision dates by country: BE: 2024-10-25, NL: 2024-11-11, DE: 2024-11-05, ES: 2024-10-23, IT: 2024-10-25

Condition(s): Metastatic Non-Small Cell Lung Cancer
Product: DOCETAXEL

Primary endpoint: Overall survival (OS)
Endpoint(s): Objective response rate (ORR) as assessed by Investigator per RECIST 1.1, Progression-free survival (PFS) as assessed by Investigator per RECIST 1.1, Incidence of TEAEs, TRAEs, irAEs, and AEs leading to treatment discontinuation.

Source: https://euclinicaltrials.eu/ctis-public/view/2023-505311-20-01